EU clinical trial 2025-522643-18-00: A Phase 3, Randomized, Placebo-Controlled Study of Adjuvant Intismeran Autogene Plus Subcutaneous Pembrolizumab and Berahyaluronidase Alfa (MK-3475A) or Intismeran Autogene Monotherapy Versus Placebo in Participants With Completely Resected High-Risk Stage I Non-Small Cell Lung Cancer (INTerpath-014)
Protocol code: V940-014
Sponsor: Merck Sharp & Dohme LLC (Pharmaceutical company). Phase: Therapeutic confirmatory (Phase III). Countries: Greece (ongoing, recruiting), Poland (authorised, recruiting), Italy (authorised, recruiting), Hungary (ongoing, recruiting), Germany (authorised, recruiting), Netherlands (authorised, recruiting), France (authorised, recruiting), Spain (ongoing, recruiting).
Therapeutic area(s): Diseases [C] - Neoplasms [C04]
Gender: Female, Male. Age: 18-64 years, 65+ years. Enrolment: 283.
Start date (EU): 2026-06-16. Decision date: 2026-06-16. Results received: No. Last updated: 2026-07-09.
Decision dates by country: DE: 2026-06-19, GR: 2026-06-17, ES: 2026-06-22, NL: 2026-06-16, PL: 2026-06-18, IT: 2026-06-22, HU: 2026-06-16, FR: 2026-07-09

Condition(s): Stage I NSCLC
Product: MK-3475A, mRNA-4157, Placebo to V940

Primary endpoint: Disease-Free Survival (DFS) as assessed by Blinded Independent Central Review (BICR) in participants with nonsquamous non-small cell lung cancer (NSCLC) in Arm A and Arm C
Endpoint(s): DFS as assessed by BICR, Distant metastasis-free survival (DMFS), Overall Survival (OS), Number Participants Who Experience an Adverse Events (AE), Number of Participants Who Discontinue Study Treatment Due to an AE, Change From Baseline in European Organization for Research and Treatment (EORTC) Quality of Life Questionnaire-Core 30 (QLQ-C30) Combined Global Health Status/Quality of Life (Items 29 & 30) Scale Combined Score, Change From Baseline in Physical Functioning (EORTC QLQ-C30 Items 1-5) Score, Change From Baseline in Role Functioning (EORTC QLQ-C30 Items 6-7) Score

Source: https://euclinicaltrials.eu/ctis-public/view/2025-522643-18-00